EU clinical trial 2025-522339-32-00: LIGHTBEAM-U01 Substudy 01D: A Phase 1b/2 Substudy to Evaluate the Safety and Efficacy of Ifinatamab Deruxtecan in Pediatric Participants With Relapsed or Refractory Solid Tumors
Protocol code: MK-9999-01D
Sponsor: Merck Sharp & Dohme LLC (Pharmaceutical company). Phase: Phase I and Phase II (Integrated)- Other. Countries: France (ongoing, recruiting), Spain (ongoing, recruiting), Sweden (ongoing, recruiting), Germany (authorised, recruitment pending), Italy (authorised, recruitment pending), Belgium (authorised, recruiting), Denmark (ongoing, recruiting), Hungary (authorised, recruitment pending).
Therapeutic area(s): Diseases [C] - Neoplasms [C04]
Gender: Female, Male. Age: 0-17 years. Enrolment: 22.
Start date (EU): 2026-06-30. Decision date: 2026-05-26. Results received: No. Last updated: 2026-07-28.
Decision dates by country: BE: 2026-05-27, DE: 2026-05-29, IT: 2026-06-01, SE: 2026-05-28, ES: 2026-05-26, FR: 2026-05-28, HU: 2026-07-28, DK: 2026-06-12

Condition(s): Neoplasm malignant
Product: Ifinatamab Deruxtecan

Primary endpoint: Part 1: Number of Participants From ≥1 Month to <12 Years Who Experience a Dose-limiting Toxicity (DLT), Part 1: Number of Participants From ≥1 Month to <12 Years Who Experience One or More Adverse Events (AEs), Part 1: Number of Participants From ≥1 Month to <12 Years Who Discontinue Study Intervention Due to an AE, Part 1: Number of Participants From ≥1 Month to <12 Years Who Receive Dose Modifications Due to AEs, Part 1 and Part 2: Objective Response Rate (ORR) for Participants with neuroblastoma (NBL), rhabdomyosarcoma (RMS), and Wilms tumor (WT), Part 1 and Part 2: Disease Control Success at 4 Months (DCS-4) for Participants with osteosarcoma (OST)
Endpoint(s): Part 1 and Part 2: Duration of Response (DOR) For Participants With NBL, RMS, WT, or OST, Part 1 and Part 2: Disease Control Rate (DCR) For Participants With NBL, RMS, WT, or OST, Part 1 and Part 2: Time to Response (TTR) For Participants With NBL, RMS, WT, or OST, Part 1 and Part 2: Progression-free Survival (PFS) For Participants With NBL, RMS, WT, or OST, Part 1 and Part 2: ORR for Participants With OST, Part 1 and Part 2: Overall Survival (OS), Part 1 and Part 2: Number of Participants With NBL, RMS, WT, or OST Who Experience One or More AEs, Part 1 and Part 2: Number of Participants With NBL, RMS, WT, or OST Who Discontinue Study Treatment Due to an AE, Part 1 and Part 2: Number of Participants With NBL, RMS, WT, or OST Who Receive Dose modifications due to AEs, Part 1 and Part 2: Maximum Plasma Concentration (Cmax) of Ifinatamab Deruxtecan (I-DXd), Part 1 and Part 2: Area Under the Concentration-Time Curve from Time 0 to the End of the Dosing Period (AUC-tau) of I-DXd, Part 1 and Part 2: Plasma Trough Concentration (Ctrough) of I-DXd, Part 1 and Part 2: Maximum Plasma Concentration (Cmax) of DXd, Part 1 and Part 2: Area Under the Concentration-Time Curve from Time 0 to the End of the Dosing Period (AUC-tau) of DXd, Part 1 and Part 2: Plasma Trough Concentration (Ctrough) of DXd, Part 1 and Part 2: Number of Participants with Antidrug Antibodies (ADA) Against I-DXd

Source: https://euclinicaltrials.eu/ctis-public/view/2025-522339-32-00